EU clinical trial 2024-513621-23-00: TACTI-004, a double-blinded, randomized phase 3 trial in patients with advanced/metastatic non-small cell lung cancer (NSCLC) receiving eftilagimod alfa (MHC class II agonist) in combination with pembrolizumab (PD-1 antagonist) and chemotherapy.
Protocol code: TACTI-004
Sponsor: Immutep (Pharmaceutical company). Phase: Therapeutic confirmatory (Phase III). Countries: Romania (ended), Lithuania (ended), Bulgaria (ended), Latvia (ended), Greece (ended), Spain (ended), Poland (ended), Belgium (ended), Hungary (ended), Croatia (ended), Germany (ended), Portugal (ended), Italy (ended), Austria (ended), Ireland (ended).
Therapeutic area(s): Diseases [C] - Neoplasms [C04]
Gender: Female, Male. Age: 18-64 years, 65+ years. Enrolment: 363.
Status: Ended. Start date (EU): 2025-04-18. End date (EU): 2026-05-26. Decision date: 2025-03-07. Results received: No. Last updated: 2026-01-12.
Decision dates by country: GR: 2025-03-10, LV: 2025-03-20, PT: 2025-03-07, RO: 2025-03-24, IT: 2025-03-25, HR: 2025-03-24, DE: 2025-03-10, PL: 2025-03-24, AT: 2025-03-21, ES: 2025-03-07, HU: 2025-03-19, LT: 2025-03-13, IE: 2025-04-17, BG: 2025-03-17, BE: 2025-04-30

Condition(s): Advanced/metastatic non-small cell lung cancer (NSCLC)
Product: KEYTRUDA 25 mg/mL concentrate for solution for infusion, PACLITAXEL, CISPLATIN, CARBOPLATIN, Pemetrexed Fresenius Kabi 25 mg/ml concentrate for solution for infusion, IMP321, KEYTRUDA 25 mg/mL concentrate for solution for infusion, KEYTRUDA 25 mg/mL concentrate for solution for infusion, Efti-matching placebo (placebo is matching the appearance and injection characteristics of efti but does not contain active substance)., KEYTRUDA 25 mg/mL concentrate for solution for infusion

Primary endpoint: Overall survival (OS) is defined as the time from randomization to death from any cause., PFS per Response Evaluation Criteria in Solid Tumors version 1.1 (RECIST 1.1), defined as the time from randomization to documented disease progression or death from any cause as assessed by the Investigator assessment based on RECIST.
Endpoint(s): ORR according to RECIST 1.1 by Investigator assessment defined as the proportion of participants who have best overall confirmed response (BOR) of complete response (CR) or partial response (PR)., Frequency, severity, and duration of adverse events (AEs), and clinically relevant abnormalities in vital signs, physical examinations, 12-lead electrocardiograms (ECGs), and safety laboratory assessments., DCR according to RECIST 1.1 by Investigator assessment defined as the proportion of participants who have BOR of confirmed CR or confirmed PR or stable disease (SD) (for ≥ 6 weeks)., DOR is defined as the time from the date a response of confirmed CR or confirmed PR was first documented until the date of the first documentation of disease progression., TTR is defined as the time from the date of first treatment to the date of the first documented confirmed CR or confirmed PR., TTNT defined from the date of randomization to the date of any post-trial procedure or therapy for the same disease., Changes from baseline in QoL as assessed by European Organization For Research And Treatment Of Cancer Quality of Life Questionnaire-C30 (EORTC QLQ-C30); EORTC QLQ-LC13 and EuroQol 5 Dimension 5 Level (EQ-5D-5L)., PFS2 defined as the time from randomization to disease progression or death from any cause (whichever occurs first) on next-line treatment.

Source: https://euclinicaltrials.eu/ctis-public/view/2024-513621-23-00